EU clinical trial 2025-523807-31-00: [22961] A placebo-controlled, parallel-group, double blind, randomized, multi-cohort Phase 2 study to investigate efficacy, safety, tolerability, pharmacodynamics and pharmacokinetics of BAY 3670549 in adult participants with atrial fibrillation.
Protocol code: 22961
Sponsor: Bayer AG (Pharmaceutical company). Phase: Therapeutic exploratory (Phase II). Countries: Belgium (authorised, recruitment pending), Germany (authorised, recruitment pending), Italy (authorised, recruitment pending).
Therapeutic area(s): Diseases [C] - Cardiovascular Diseases [C14]
Gender: Female, Male. Age: 18-64 years, 65+ years. Enrolment: 45.
Status: Authorised, recruitment pending. Decision date: 2026-08-06. Results received: No. Last updated: 2026-08-07.
Decision dates by country: BE: 2026-08-06, DE: 2026-08-07, IT: 2026-08-07

Condition(s): Atrial fibrillation
Product: Placebo to BAY 3670549, BAY 3670549 Bayer

Primary endpoint: Participants with conversion from atrial fibrillation (AF) to sinus rhythm (SR), sustained for ≥1 minute, within 3 hours after start of study intervention administration, and prior to use of rescue therapy or other SoC for cardioversion
Endpoint(s): Participants who experienced Treatment Emergent Adverse Events (TEAE)s, Time to conversion from AF to SR as defined in the primary endpoint, Participants in SR, at 3 hours after start of study intervention administration without prior use of rescue therapy or other SoC for cardioversion, Plasma concentration of BAY 3670549 at the end of the infusion

Source: https://euclinicaltrials.eu/ctis-public/view/2025-523807-31-00